EU clinical trial 2023-510155-37-00: A phase 3, multicenter, open label, randomized, non-comparative two-arm study of ivosidenib (IVO) monotherapy and azacitidine (AZA) monotherapy in adult patients with hypomethylating agent (HMA) naive myelodysplastic syndromes (MDS) with an isocitrate dehydrogenase-1 (IDH1) mutation (PyramIDH study).
Protocol code: S095031-178
Sponsor: Institut De Recherches Internationales Servier IRIS (Pharmaceutical company). Phase: Therapeutic confirmatory (Phase III). Countries: Netherlands (ongoing, recruiting), Spain (ongoing, recruiting), France (ongoing, recruiting), Italy (ongoing, recruiting), Germany (ongoing, recruiting).
Therapeutic area(s): Diseases [C] - Hemic and Lymphatic Diseases [C15]
Gender: Female, Male. Age: 18-64 years, 65+ years. Enrolment: 26.
Status: Ongoing, recruiting. Start date (EU): 2025-05-08. Decision date: 2024-12-02. Results received: No. Last updated: 2026-04-30.
Decision dates by country: FR: 2024-12-05, NL: 2024-12-09, ES: 2024-12-02, DE: 2024-12-03, IT: 2024-12-04

Condition(s): Hypomethylating agent (HMA) naive myelodysplastic syndromes Myelodysplastic Symdrome (MDS), Myelodysplastic Symdrome (MDS)
Product: Vidaza 25 mg/ml powder for suspension for injection, AG-120/S95031 250mg film-coated tablet

Primary endpoint: Complete remission (CR) + Partial remission (PR) by 4 months as per IWG 2006 criteria.
Endpoint(s): Overall Response (OR) rate per IWG 2023 criteria defined as CR (or CR equivalent) + PR + CRL + CRh + hematological improvement (HI)., Event-free survival (EFS) defined as the date of randomization to the date of first documented confirmed relapse/progression/death, whichever occurs first., Overall Survival (OS) defined as the time from randomization to the date of death due to any cause. Participants who are alive at the analysis cutoff date will be censored at the date they were last known to be alive., Duration of CR and PR among participants who achieve CR + PR per IWG 2006 criteria., Time to CR and PR defined as time from the date of the randomization to the date of CR+PR, among participants who achieve CR+PR based on IWG 2006 Response Criteria., Acute myeloid leukemia (AML) transformation rate, Time to transfusion independence (TTTI) defined as time from date of randomization to date transfusion independence (TI) is first observed (Day 1 of a ≥ 56 days period without a transfusion), among participants who are baseline transfusion dependent and have achieved post-baseline TI. In the event a participant had more than one ≥ 56-day period, which met TI criteria, the earliest period will be used in analysis., Duration of transfusion independence (DOTI) among participants who have achieved post-baseline TI, DOTI will be calculated as the time from the date TI is first observed (Day 1 of a ≥ 56-day period without a transfusion) until the day before the participants had a subsequent transfusion., Transfusion independence rate, Quality of Life in Myelodysplasia Scale (QUALMS) scores range from 0 to 100, with a higher score representing a better QOL., Change from baseline in health economic outcomes measures based on EQ-5D-5L score. Health economic outcomes measures as assessed by the 5-level EuroQol five dimensions questionnaire (EQ-5D-5L) scores range from 5 to 25 with a higher number representing a worse health status., Number of participants who proceed to hematopoietic stem cell transplantation (HSCT)., Ivosidenib plasma concentration and 2-HG plasma concentrations for participants receiving Ivosidenib monotherapy., Number of participants achieving CR and PR by 6 months as per IWG 2006 criteria., Number of participants achieving CR and PR by 6 months as per IWG 2023 criteria., Number of participants achieving CR and PR by 4 months as per IWG 2023 criteria., Number of adverse events (AEs) and serious adverse events (SAEs)., Health economic outcomes measures as assessed by the 5-level EuroQol five dimensions questionnaire (EQ-5D-5L) scores range from 5 to 25 with a higher number representing a worse health status.

Source: https://euclinicaltrials.eu/ctis-public/view/2023-510155-37-00